EU clinical trial 2024-513894-35-00: OSU6162 as add-on in SSRI/SNRI-resistant depression (ODEN): a double-blind, placebo-controlled evaluation of efficacy and safety
Sponsor: University Of Gothenburg (Educational Institution). Phase: Therapeutic exploratory (Phase II). Countries: Sweden (authorised, recruitment pending).
Therapeutic area(s): Psychiatry and Psychology [F] - Behavioral Disciplines and Activities [F04]; Psychiatry and Psychology [F] - Mental Disorders [F03]
Gender: Female, Male. Age: 18-64 years. Enrolment: 180.
Status: Authorised, recruitment pending. Decision date: 2024-10-25. Results received: No. Last updated: 2024-10-25.

Condition(s): Depression
Product: OSU6162 15 mg, Placebo

Primary endpoint: Change from baseline with respect to the total score of the investigator-rated Bech 6-item subscale of the Hamilton Depression Rating Scale (HDRS) at endpoint (10).

Source: https://euclinicaltrials.eu/ctis-public/view/2024-513894-35-00